EU clinical trial 2023-507905-33-00: A First-in-human study to learn how safe the study drug BAY2965501 is, find the best dose (single drug & combination), how it affects the body, what maximum amount can be given, how it moves into, through and out of the body, how it acts on different tumors in participants with advanced solid tumors
Protocol code: 21948
Sponsor: Bayer AG (Pharmaceutical company). Phase: Human Pharmacology (Phase I)- First administration to humans. Countries: Belgium (ended), Spain (ended).
Therapeutic area(s): Diseases [C] - Neoplasms [C04]
Gender: Female, Male. Age: 18-64 years, 65+ years. Enrolment: 97.
Status: Ended. Start date (EU): 2025-09-30. End date (EU): 2026-01-09. Decision date: 2024-04-16. Results received: No. Last updated: 2025-12-01.
Decision dates by country: BE: 2024-04-22, ES: 2024-04-16

Condition(s): Advanced solid tumors

Source: https://euclinicaltrials.eu/ctis-public/view/2023-507905-33-00